EU clinical trial 2024-513572-17-00: A Phase 3, Multicenter, Randomized, Double-Blind, Placebo-Controlled, 12-Week Study (Part A) with a 40 Week Open-Label Extension (Part B) Evaluating the Efficacy and Safety of Oral MM120 Compared to Placebo in the Treatment of Adults with Generalized Anxiety Disorder - Panorama
Protocol code: MM120-301
Sponsor: Definium Therapeutics US Inc. (Pharmaceutical company). Phase: Therapeutic confirmatory (Phase III). Countries: France (ongoing, recruitment ended), Czechia (ongoing, recruitment ended), Germany (ongoing, recruitment ended), Poland (ongoing, recruitment ended).
Therapeutic area(s): Psychiatry and Psychology [F] - Mental Disorders [F03]
Gender: Female, Male. Age: 18-64 years, 65+ years. Enrolment: 201.
Status: Ongoing, recruitment ended. Start date (EU): 2025-08-20. Decision date: 2025-02-19. Results received: No. Last updated: 2026-07-16.
Decision dates by country: FR: 2025-02-20, PL: 2025-03-02, DE: 2025-02-19, CZ: 2025-02-24

Condition(s): Generalized Anxiety Disorder (GAD)
Product: MM120, Placebo, MM120

Primary endpoint: Double-blind Period (Part A): Change from Baseline in Hamilton Anxiety Rating Scale (HAM-A) total score at Week 12.
Endpoint(s): Double-blind Period (Part A): Change from Baseline in HAM-A total score at Week 8, Week 4, Week 2, and Week 1. HAM-A response/remission at each timepoint assessed during 12-week double-blind period. A full description of this endpoint can be found in the protocol., Open-label Extension (Part B): HAM-A response (reduction from Baseline score of ≥50%) at each timepoint assessed during the 40 week open-label period. A full description of this endpoint can be found in the protocol., Open label extension (Part B): Change from Double-blind Baseline at each timepoint assessed during the 40-week open-label period in the following: • HAM-A/ MADRS total score • CGI-S/ PGI-S Scale score • WPAI • EQ-5D-5L., Open label extension (Part B): CSFQ-14 total score at each timepoint assessed during the open-label period. Percent of men and women with normal and abnormal sexual functioning at each timepoint assessed during the open-label period., Double-blind Period (Part A) key secondary: Change from Baseline to Week 12 in CGI-S scale score, to Week 1 in HAM-A total score, to Day 2 in CGI-S score., Part A and B: Percent of participants requiring 1, 2, 3, 4, or 5 doses of MM120 during the 52-week study (Part A and Part B) as assessed by participants meeting protocol-specified retreatment criteria during the 40-week open-label period. Need for MM120 treatment as assessed by the average number of MM120 treatments received., Part A and B: Single dose durability as assessed by time to event where (CCI) GAD symptoms resurfaced (see details in the Statistical Analysis Plan [SAP]). Time from first dose (Part A) to first retreatment in the open-label period (Part B)

Source: https://euclinicaltrials.eu/ctis-public/view/2024-513572-17-00